EU clinical trial 2024-512050-13-00: EPIK-B2: A two part, Phase III, multicenter, randomized (1:1), double-blind, placebo-controlled study to assess the efficacy and safety of alpelisib (BYL719) in combination with trastuzumab and pertuzumab as maintenance therapy in patients with HER2-positive advanced breast cancer with a PIK3CA mutation
Protocol code: CBYL719G12301
Sponsor: Novartis Pharma AG (Pharmaceutical company). Phase: Therapeutic confirmatory (Phase III). Countries: France (ended).
Therapeutic area(s): Diseases [C] - Neoplasms [C04]
Gender: Female, Male. Age: 18-64 years, 65+ years. Enrolment: 2.
Status: Ended. Start date (EU): 2020-09-22. End date (EU): 2025-11-07. Decision date: 2024-07-23. Results received: No. Last updated: 2025-12-16.

Condition(s): HER2-positive advanced breast cancer
Product: ALPELISIB, TRASTUZUMAB, PERTUZUMAB, ALPELISIB

Primary endpoint: Safety run-in Part 1: Incidence of DLTs during the first 6 weeks of treatment for each dose level associated with administration of alpelisib in combination with trastuzumab and pertuzumab, Double-blind, randomized, placebo-controlled Part 2: PFS based on Investigator assessment using RECIST 1.1 criteria
Endpoint(s): Safety run-in Part 1: Safety: Incidence, type, and severity of adverse events per Common Terminology Criteria for Adverse Events (CTCAE) version 4.03 criteria including changes in laboratory values, vital signs, liver assessments and cardiac assessments Tolerability: dose interruptions, reductions, dose intensity, and duration of exposure for all drug components, Safety run-in Part 1: Summary statistics of alpelisib concentrations by timepoint and dose level, Double-blind, randomized, placebo-controlled Part 2: OS, Double-blind, randomized, placebo-controlled Part 2: Safety: Incidence, type, and severity of adverse events per CTCAE version 4.03 criteria including changes in laboratory values, vital signs, liver assessments and cardiac assessments Tolerability: dose interruptions, reductions, dose intensity, and duration of exposure for all drug components, Double-blind, randomized, placebo-controlled Part 2: ORR with confirmed response, CBR with confirmed response, DOR with confirmed response, and TTR based on local radiology assessments and using RECIST 1.1 criteria., Double-blind, randomized, placebo-controlled Part 2: Summary statistics of concentrations for alpelisib by time point, Double-blind, randomized, placebo-controlled Part 2: Change from baseline in the FACT-B Trial Outcomes Index (TOI) score. Time to 5-point definitive deterioration in the TOI score of the FACT-B, Double-blind, randomized, placebo-controlled Part 2: PFS based on local radiology assessments and using RECIST 1.1 criteria for participants by PIK3CA mutation status assessed in ctDNA at baseline, Double-blind, randomized, placebo-controlled Part 2: Time to definitive deterioration of the ECOG performance status from baseline

Source: https://euclinicaltrials.eu/ctis-public/view/2024-512050-13-00